EU clinical trial 2023-509627-40-01: Efficacy of daily IV administration of dornase alfa for up to 14 days post subarachnoid haemorrhage on functional independence at 6 months: a multicentre open-label randomised controlled trial of the PROBE type Probe
Sponsor: Hopital Fondation Adolphe De Rothschild (Hospital/Clinic/Other health care facility). Phase: Therapeutic confirmatory (Phase III). Countries: France (ongoing, recruiting).
Therapeutic area(s): Diseases [C] - Nervous System Diseases [C10]
Gender: Female, Male. Age: 18-64 years, 65+ years. Enrolment: 304.
Status: Ongoing, recruiting. Start date (EU): 2025-05-15. Decision date: 2024-10-31. Results received: No. Last updated: 2026-03-25.

Condition(s): subarachnoid hemorrhage
Product: PULMOZYME 2500 U/2,5 ml, solution pour inhalation par nébuliseur

Primary endpoint: Excellent functional prognosis defined by a score of 0 or 1 on the modified Rankin Scale (mRS) at 6 months. Assessment will be centralised and carried out by telephone by a certified professional, blinded to the randomisation arm.
Endpoint(s): Focal neurological deficit or decrease in Glasgow score (at least 2 points for at least 1 hour), not immediately after aneurysmal occlusion and not entirely related to another cause (verified by clinical, biological and radiological means), according to the SAHIT (Subarachnoid Hemorrhage International Trialists) definition., Modified Rankin Scale (mRS) score at 6 months, Ischaemic lesions on MRI at D21 post-HSA (or at discharge if before D21). MRI scans will be analysed centrally by a radiologist blinded to the randomisation arm., Treatment of vasospasm defined by one of the following interventions: endovascular treatment or IV infusion of milrinone or increase in blood pressure by vasopressor drugs., Number of days among the 21 days post-HSA (or discharge from hospital if before D21) with prescription of one or more of the treatments mentioned in criterion 4, MoCA-5min score at 6 months, All-cause mortality at D21 (or at hospital discharge if before D21), Serious adverse event, Change in NETs blood concentration between sampling at inclusion and sampling at D21 (or at discharge if before D21)., Score on the Subarachnoid Haemorrhage-Specific Outcome Tool (SAHOT) scale at 6 months, Score on the Stroke Impact Scale-16 (SIS-16) at 6 months

Source: https://euclinicaltrials.eu/ctis-public/view/2023-509627-40-01